EU clinical trial 2024-513077-48-00: A Phase 3, open-label, randomized 2-arm study comparing the clinical efficacy and safety of niraparib with temozolomide in adult participants with newly-diagnosed, MGMT unmethylated glioblastoma
Protocol code: IVY-P3-24-021
Sponsor: Neurotrials LLC (Laboratory/Research/Testing facility). Phase: Therapeutic confirmatory (Phase III). Countries: Norway (ongoing, recruitment ended), Denmark (authorised, recruitment pending), Netherlands (ongoing, recruitment ended), Spain (ongoing, recruitment ended), France (ongoing, recruitment ended), Italy (ongoing, recruitment ended), Germany (ongoing, recruitment ended), Ireland (authorised, recruitment pending).
Therapeutic area(s): Diseases [C] - Neoplasms [C04]
Gender: Female, Male. Age: 18-64 years, 65+ years. Enrolment: 215.
Start date (EU): 2024-12-19. Decision date: 2024-12-02. Results received: No. Last updated: 2026-06-23.
Decision dates by country: DK: 2024-12-02, IE: 2025-09-12, NO: 2024-12-02, FR: 2024-12-05, DE: 2024-12-03, NL: 2024-12-09, ES: 2024-12-02, IT: 2024-12-06

Condition(s): O6-methylguanine methyltransferase (MGMT) unmethylated glioblastoma
Product: TEMOZOLOMIDE, Zejula 100 mg film-coated tablets

Primary endpoint: Overall survival, defined as the time from the date of randomization to the date of death due to any cause
Endpoint(s): Overall response rate, defined as confirmed complete response or confirmed partial response, as per RANO 2.0 by BICR assessment, Compare symptoms, function, and HRQoL at baseline to the specified timepoints in the schedule of assessments, Changes from baseline in neurocognitive function assessed by Hopkins Verbal Learning Test, Controlled Oral Word Association, and Trail Making Test Parts A and B, • Incidence of AEs, SAEs, and AESIs • Incidence of treatment discontinuations, dose interruptions, and dose reductions due to AEs, SAEs, or AESIs, changes in Karnofsky performance status, changes in clinical laboratory results, and vital sign measurements • Frequency and severity of symptomatic AEs based on PRO-CTCAE, Progression-free survival, defined as the time from the date of randomization to the date of first disease progression per RANO 2.0 by BICR assessment or death from any cause, whichever occurs first

Source: https://euclinicaltrials.eu/ctis-public/view/2024-513077-48-00